EU clinical trial 2024-516248-24-00: A Long-term, Open-label Study to Evaluate the Safety and Efficacy of Orally Administered Deucrictibant Extended-Release Tablet for Prophylaxis Against Angioedema Attacks in Adolescents and Adults with Hereditary Angioedema
Protocol code: PHA022121-C307
Sponsor: Pharvaris Netherlands B.V. (Pharmaceutical company). Phase: Therapeutic confirmatory (Phase III). Countries: France (ongoing, recruiting), Hungary (ongoing, recruiting), Italy (ongoing, recruiting), Slovakia (ongoing, recruiting), Germany (ongoing, recruiting), Ireland (ongoing, recruiting), Austria (ongoing, recruiting), Poland (ongoing, recruiting), Romania (ended), Spain (ongoing, recruiting), Bulgaria (ongoing, recruiting).
Therapeutic area(s): Diseases [C] - Congenital, Hereditary, and Neonatal Diseases and Abnormalities [C16]
Gender: Female, Male. Age: 0-17 years, 18-64 years, 65+ years. Enrolment: 78.
Start date (EU): 2025-03-28. Decision date: 2025-03-04. Results received: No. Last updated: 2026-08-07.
Decision dates by country: ES: 2025-03-04, AT: 2025-03-10, HU: 2025-03-10, RO: 2025-03-10, PL: 2025-03-09, BG: 2025-03-07, DE: 2025-03-04, FR: 2025-03-04, IE: 2025-03-07, SK: 2025-03-04, IT: 2025-03-04

Condition(s): Hereditary Angioedema
Product: Deucrictibant (PHA-022121)

Primary endpoint: Treatment-emergent adverse events (TEAEs), including serious adverse events (SAEs), adverse events of special interest (AESIs), and TEAEs leading to study drug discontinuation, Clinical laboratory tests, Vital signs, Electrocardiogram (ECG) parameters
Endpoint(s): Time-normalized (per 4 weeks) number of Investigator-confirmed HAE attacks during the Treatment Period, Time-normalized number of Investigator-confirmed HAE attacks treated with on-demand medication during the Treatment Period, Time-normalized number of Investigator-confirmed moderate or severe HAE attacks during Treatment Period, Time-normalized number of Investigator-confirmed severe HAE attacks during the Treatment Period, Proportion of time without angioedema symptoms during the Treatment Period, Angioedema Quality of Life (AE-QoL) questionnaire, Patient Global Assessment of Change (PGA-Change), Angioedema Control Test 4-week version (AECT-4wk), Work Productivity and Activity Impairment Questionnaire: Specific Health Problem (WPAI-SHP), Abbreviated Treatment Satisfaction Questionnaire for Medication (TSQM-9), Pre-dose plasma concentration of deucrictibant and deucricitbant metabolites (Ctrough), Urine concentration of deucrictibant and deucrictibant metabolites

Source: https://euclinicaltrials.eu/ctis-public/view/2024-516248-24-00